EU clinical trial 2024-513070-21-00: International Study for Treatment of High Risk Childhood Relapsed ALL 2010 - A randomized Phase II Study Conducted by the Resistant Disease Committee of the International BFM Study Group – IntReALL HR 2010
Protocol code: IntReALL HR 2010
Sponsor: Charite Universitaetsmedizin Berlin KöR (Hospital/Clinic/Other health care facility). Phase: Therapeutic exploratory (Phase II). Countries: Czechia (ongoing, recruiting), Spain (ongoing, recruiting), Belgium (ongoing, recruiting), Netherlands (ongoing, recruiting), France (ended), Germany (ongoing, recruiting), Italy (ongoing, recruiting), Austria (ongoing, recruiting), Poland (ended), Finland (ended), Portugal (ongoing, recruiting).
Therapeutic area(s): Diseases [C] - Neoplasms [C04]
Gender: Female, Male. Age: 0-17 years. Enrolment: 222.
Start date (EU): 2018-02-15. Decision date: 2024-09-30. Results received: No. Last updated: 2026-03-11.
Decision dates by country: FR: 2024-10-02, BE: 2024-09-30, CZ: 2024-10-01, FI: 2024-10-04, IT: 2024-11-18, ES: 2024-09-30, PL: 2024-11-13, AT: 2024-10-07, NL: 2024-09-30, PT: 2025-02-13, DE: 2024-10-07

Condition(s): Relapsed Acute Lymphoblastic Leukemia (ALL)
Product: Dexamethasone phosphate Accord 4 mg/ml injeksjons-/infusjonsvæske, oppløsning, VELCADE 3.5 mg powder for solution for injection, METHOTREXATE VIATRIS 100 mg/ml, solution injectable, Oncaspar 750 U/ml powder for solution for injection/infusion, Vincristine Sulfate 1 mg/ml Solution for Injection or Infusion, Mitoxantrone 2 mg/ml concentrate for solution for infusion

Primary endpoint: Randomized induction trial: Improvement of CR2 rates with standard chemotherapy + Bortezomib (Arm B) quantified by cytology compared with standard chemotherapy (Arm A)
Endpoint(s): Improvement of three years EFS and OS, rate of patients reaching HSCT, MRD rates post induction and pre-HSCT, prognostic relevance of MRD pre HSCT, CR2 and MRD rates during consolidation, toxicity of randomized arms

Source: https://euclinicaltrials.eu/ctis-public/view/2024-513070-21-00